EU clinical trial 2024-520058-39-00: A Phase 4 (Phase 2 in European Union), Open-Label, Multicenter Study Evaluating the Absorption and Systemic Pharmacokinetics and HPA Axis Suppression Potential of Topically Applied IDP-122 Lotion in Pediatric Subjects with Moderate to Severe Plaque Psoriasis
Protocol code: V01-122A-401
Sponsor: Bausch Health Americas Inc. (Pharmaceutical company). Phase: Therapeutic exploratory (Phase II). Countries: Poland (ongoing, recruitment ended).
Therapeutic area(s): Diseases [C] - Skin and Connective Tissue Diseases [C17]
Gender: Female, Male. Age: 0-17 years, 65+ years. Enrolment: 26.
Status: Ongoing, recruitment ended. Start date (EU): 2020-12-28. Decision date: 2025-01-28. Results received: No. Last updated: 2025-01-28.

Condition(s): Plaque Psoriasis
Product: Bryhali

Primary endpoint: 1 Safety of IDP-122 (HP 0.01%) Lotion administered topically once daily 2 Systemic exposure of HP after topical application of IDP-122 Lotion once daily 3 Hypothalamic-pituitary-adrenal (HPA) axis suppression potential for IDP-122 Lotion when applied once daily

Source: https://euclinicaltrials.eu/ctis-public/view/2024-520058-39-00